EU clinical trial 2023-509421-41-03: AUTOP 2 : Screen-and-treat strategy for vaginal flora abnormalities by molecular biology in pregnant women at high risk of preterm birth: A Multicentre, Randomized Study
Protocol code: AUTOP 2
Sponsor: Assistance Publique Hopitaux De Marseille (Hospital/Clinic/Other health care facility). Phase: Therapeutic confirmatory (Phase III). Countries: France (authorised, recruitment pending).
Therapeutic area(s): Diseases [C] - Female Urogenital Diseases and Pregnancy Complications [C13]; Diseases [C] - Bacterial Infections and Mycoses [C01]
Gender: Female. Age: 18-64 years. Enrolment: 1794.
Status: Authorised, recruitment pending. Decision date: 2026-04-01. Results received: No. Last updated: 2026-04-01.

Condition(s): Bacterial vaginosis, High risk preterm birth pregnancy, Vaginal flora abnormalities
Product: MYCOHYDRALIN 500 mg, capsule vaginale, FLAGYL 500 mg, comprimé pelliculé, ZITHROMAX 250 mg, comprimé pelliculé, ROCEPHINE 1 g/3,5 ml, poudre et solvant pour solution injectable (IM), GRANUDOXY 100 mg, comprimé pelliculé sécable

Primary endpoint: The rate of preterm birth before 37 weeks of gestation, which will be compared between the innovative group (Group A experimental) and the standard group (Group B Usual care)
Endpoint(s): Severity criteria of prematurity: the rates of delivery before 23, 24, 26, 28, 32 and 37 weeks of gestation, Morbidity during pregnancy: The rate of preterm rupture of the membranes defined as clean break with evident flow of amniotic fluid and/or a positive Amnicator, AmniSure, Actim PROM (IGFBP-1) test, Morbidity during pregnancy: The rate of late fetal loss ( name also late miscarriage) between 14 and 22 weeks of gestation, Morbidity during pregnancy: The rate of fetal growth restriction defined as an abdominal and/or femoral circumference measurement < 5th percentile for the gestational age according to OMS, Morbidity during pregnancy: The rate of endometritis characterized by a uterus that is painful on mobilization, the presence of purulent vaginal discharge (with the presence of altered leukocytes on vaginal swabbing) and hyperthermia >38°C requiring antibiotic therapy (with a negative result upon cytobacteriologic examination of the urine), Morbidity during pregnancy: The rate of spontaneous preterm birth calculated as follows: patients with caesarean section or labor induced before 37 weeks’ gestation for any of the following reasons: preeclampsia, retroplacental hematoma, fetal heart rhythm abnormality, fetal growth restriction or in utero fetal death of vascular origin, medical termination of pregnancy for fetal malformation or chromosomal abnormalities will be excluded from this adjusted preterm birth rate, Morbidity during pregnancy: The rate of risk of preterm birth defined by uterine contractions occurring before 37 weeks’ gestation and/or a cervical length of less than 25 mm on vaginal ultrasound, Morbidity during pregnancy: The rate of progestative treatment, Morbidity during pregnancy: The rate of emergency cerclage, Total inpatient stay: the total length, antepartum and postpartum, of hospitalization for mother and newborn in number of days (including conventional hospitalization, day hospitalization and hospitalization at home, hospitalization in neonatology or intensive care unit), Neonatal mortality: the rate of death after 22 weeks’ gestation and until hospital discharge, Neonatal morbidity, which will be compared between the innovative group and the standard group until hospital discharge, by the occurrence of the following clinical events: respiratory distress syndrome, bronchopulmonary dysplasia, rate of `intraventricular hemorrhage, periventricular leukomalacia, necrotizing enterocolitis, sepsis, retinopathy of prematurity, newborns admitted to intensive care unit, mechanical ventilation, length of stay in intensive care unit., The rate of spontaneous abortion before 14 weeks’ gestation (13 weeks and 6 days) and before 22 week's gestation., In Group A: The effectiveness of the treatment will be assessed by comparing the quantitative loads of hosts quantified by molecular biology before and after treatments., In group A: The rate of successful treatment (determined by a negative molecular analysis at the first vaginal sample control), In group A: The rate of recurrence will be determined by molecular analysis during follow-up of positive patients and defined as a positive result after a negative result control in this group of patients., In group A: the rate of positivity for each host before and after treatments, In group A: The rate of preterm birth of women with an initial success of treatment (based on a negative result for the screening test conducted for recurrence), In group A: The rate of preterm birth among women with either a positive POC or a negative POC test, In group A: The rate of preterm birth according to the results of POC and the specy, In group B: The proportion, type of screening and management of BV and its recurrence detected by traditional methods (Nugent score, etc.) for the standard strategy. The proportion of women under 25 years or at risk of sexual transmitted infection, positive for C. trachomatis., Health economic: Incremental cost-effectiveness ratio, Health economic: Budget impact, Health economic: Indicators of process, Exploratory: description of the metagenomic and culturomic analysis performed on a sample of patients.

Source: https://euclinicaltrials.eu/ctis-public/view/2023-509421-41-03